EU clinical trial 2022-501986-38-00: Phase 1 Dose Escalation Study Assessing the Safety and Pharmacokinetics of PTC844 in Healthy Participants
Protocol code: PTC844-SMAD-101-HV
Sponsor: PTC Therapeutics Inc. (Pharmaceutical company). Phase: Human Pharmacology (Phase I)- First administration to humans. Countries: Netherlands (ended).
Therapeutic area(s): Not possible to specify
Gender: Female, Male. Age: 18-64 years. Enrolment: 64.
Status: Ended. Start date (EU): 2022-12-30. End date (EU): 2023-12-22. Decision date: 2022-12-23. Results received: Yes. Last updated: 2024-01-08.

Condition(s): Auto immune disorders
Product: PTC844, Matching placebo

Primary endpoint: Type, frequency, severity, timing, and relationship to study intervention of any adverse events (AEs) and abnormalities in clinical laboratory, electrocardiograms (ECGs), vital signs, and/or physical examinations when PTC844 is administered as single or multiple doses.
Endpoint(s): PTC844 plasma concentrations and PK parameters including Cmax, Tmax, kel, T1/2, AUC0-last, AUC0-inf, %AUCextra, AUC0-24, CL/F, CLss/F, Vz/F, Ra, and dosenormalized Cmax, AUC0-last, and AUC0-inf, as appropriate, when PTC844 is administered as single or multiple doses.

Source: https://euclinicaltrials.eu/ctis-public/view/2022-501986-38-00